EU clinical trial 2024-512731-74-00: Venetoclax and Dexamethasone in translocation (11;14) positive relapsed and refractory multiple myeloma (VICTORIA)
Sponsor: Lillebaelt Hospital (Hospital/Clinic/Other health care facility). Phase: Therapeutic exploratory (Phase II). Countries: Denmark (ongoing, recruitment ended).
Therapeutic area(s): Diseases [C] - Neoplasms [C04]; Diseases [C] - Hemic and Lymphatic Diseases [C15]
Gender: Female, Male. Age: 18-64 years, 65+ years. Enrolment: 50.
Status: Ongoing, recruitment ended. Start date (EU): 2020-07-03. Decision date: 2024-04-09. Results received: No. Last updated: 2025-01-09.

Condition(s): multiple myeloma
Product: VENETOCLAX, Prevenar 13 suspension for injection in single dose vial pneumococcal polysaccharide conjugate vaccine (13-valent, adsorbed), Dexamethasone 4 mg tablets, Pneumovax, injektionsvæske, opløsning i fyldt injektionssprøjte

Primary endpoint: To evaluate the overall response rate (partial response or better) of the combination of Venetoclax-dexamethasone in patients with relapsed or refractory multiple myeloma
Endpoint(s): progression-free survival, clinical benefit rate (minimal response or better), time to next treatment, overall survival, time to response, duration of response, safety and tolerability, discontinuation rate, quality of life, number of serious adverse events due to infections, duration of hospital admissions due to infections, effect of PET-positivity on efficacy end-points, Estimation of humoral immunodeficiency of subjects at baseline by measuring serum anti-pneumococcal polysaccharide IgG, IgA, IgM antibodies, assessment of the relation of humoral immunodeficiency to infections, assessment of pneumococcal vaccination response and its relation to infections, estimation of Bcl-2 overexpression by immunohistochemistry, assessment of the relation of Bcl-2 overexpression to the efficacy of the study treatment

Source: https://euclinicaltrials.eu/ctis-public/view/2024-512731-74-00